EU clinical trial 2024-514023-42-00: ACAV: EFFICACY AND SAFETY OF ALIROCUMAB TO PREVENT EARLY CARDIAC ALLOGRAFT VASCULOPATHY IN RECENT HEART TRANSPLANT RECIPIENTS
Protocol code: ACAV2018
Sponsor: Institute For Clinical And Experimental Medicine (Hospital/Clinic/Other health care facility). Phase: Therapeutic use (Phase IV). Countries: Czechia (ended).
Therapeutic area(s): Diseases [C] - Cardiovascular Diseases [C14]
Gender: Female, Male. Age: 18-64 years, 65+ years. Enrolment: 126.
Status: Ended. Start date (EU): 2019-11-27. End date (EU): 2025-05-05. Decision date: 2024-12-09. Results received: Yes. Last updated: 2024-12-09.

Condition(s): Cardiac allograft vaculopathy in recent heart transplant recipients
Product: Alirocumab, Placebo product for REGN727

Primary endpoint: Mean level of LDL-C, HDL-C, TC, TG, ApoB, Lp[a], ApoA1 at treatment visit 2, 3, 4, 5 and 6.
Endpoint(s): Percent change from baseline in calculated LDL-C at Treatment visit 6, Calculated LDL-cholesterol at every study visit (Treatment visit 1, 2, 3, 4, 5, and Visit 6), Difference in other lipids and lipoproteins (TC, HDL-C, ApoB, ApoA1, Lp(a), TG) at every study visit (Treatment visit 1, 2, 3, 4, 5, and Visit 6), Change of LDL-C and the other parameters of lipid profile (TC, HDL-C, ApoB, ApoA1, Lp(a), TG) between Treatment visit 6 and Visit 7, Difference in mean of intimal thickness change (between Treatment visit 6 – Treatment visit 1) assessed by OCT, Difference in mean lumen volume change (between Treatment visit 6 – Treatment visit 1) assessed by OCT.

Source: https://euclinicaltrials.eu/ctis-public/view/2024-514023-42-00